EU clinical trial 2024-512453-25-00: Efficacy, tolerability and preferences of per oral or subcutaneous methotrexate in patients with early rheumatoid arthritis – a randomised register based multicentre study
Protocol code: MTXRA
Sponsor: Region Vaesterbotten (Hospital/Clinic/Other health care facility). Phase: Therapeutic use (Phase IV). Countries: Sweden (ongoing, recruitment ended).
Therapeutic area(s): Diseases [C] - Musculoskeletal Diseases [C05]
Gender: Female, Male. Age: 18-64 years, 65+ years. Enrolment: 212.
Status: Ongoing, recruitment ended. Start date (EU): 2022-04-28. Decision date: 2024-07-03. Results received: No. Last updated: 2025-03-17.

Condition(s): Rheumatoid arthritis
Product: METHOTREXATE, METHOTREXATE

Primary endpoint: DAS28
Endpoint(s): Number of swollen joints, Number of tender joints, HAQ, VAS pain, VAS general health, VAS fatigue, Doctor's global assessment, Number of individuals remaining on the designated drug (drug retention) including number of individuals prescribed biologic treatment, Number of patient´s contact with any health care giver, All other medications, including corticosteroids, other csDMARDs, biologics, intraarticular injections as well as change in dosage or administration route of methotrexate, ESR, CRP, Number of AE, Patients preferences, EQ5D, Gutmicrobiota, Questions on diet and alcohol consumption

Source: https://euclinicaltrials.eu/ctis-public/view/2024-512453-25-00